EU clinical trial 2024-513824-41-00: A Randomized Trial of the I-BFM-SG for the Management of Childhood non-mature-B Acute Lymphoblastic Leukemia
Protocol code: ALLIC-BFM2022
Sponsor: Semmelweis University (Educational Institution). Phase: Therapeutic use (Phase IV). Countries: Greece (authorised, recruitment pending), Hungary (authorised, recruitment pending), Croatia (authorised, recruitment pending), Slovenia (authorised, recruitment pending).
Therapeutic area(s): Analytical, Diagnostic and Therapeutic Techniques and Equipment [E] - Therapeutics [E02]
Gender: Female, Male. Age: 0-17 years. Enrolment: 775.
Status: Authorised, recruitment pending. Decision date: 2024-12-08. Results received: No. Last updated: 2026-06-01.
Decision dates by country: HR: 2025-01-13, GR: 2025-01-09, HU: 2024-12-08, SI: 2024-12-18

Condition(s): Childhood non-mature-B Acute Lymphoblastic Leukemia
Product: Riximyo 500 mg concentrate for solution for infusion, Oncaspar 750 U/ml powder for solution for injection/infusion

Primary endpoint: The primary endpoint will be the minimum time from the randomization until the first event: non-response after HR2 consolidation block, relapse, second malignancy or death from any cause (EFS time).
Endpoint(s): Time to death from any cause, measured from the time of randomization (survival time)., End of induction (day 33) and end of early intensification (day 78) MRD status., Safety of rituximab in combination with intensive chemotherapy: -Death in CR will be compared between the two arms. -The rate of severe infections (CTC grade 3 to 5) during the treatment and until the end of chemotherapy will be compared between the two arms. -The rate of rituximab infusion reactions (total number and by severity of reactions) will be estimated. -The rate of intensive care unit admissions will be compared between the two arms., -Occurrence of infections on the target list (presumably associated with rituximab) will be compared between the two arms: cytomegalovirus, progressive multifocal leukoencephalopathy and Herpes zoster. -Need for immunoglobulin substitution will be compared between the two arms. IgG level will be measured at day 0 and then by physician discretion, but at least once monthly until the end of intensive chemotherapy and once every 3 months during maintenance chemotherapy until reaching normal level w, Additional Researchs: -To determine the relationship between CD20 expression on ALL blasts (initially, day 15, day 33, day 78) and response to monoclonal antibody therapy. -To determine whether the administration of an anti-B cell monoclonal antibody limits the incidence of peg-asparaginase allergy occurrence.

Source: https://euclinicaltrials.eu/ctis-public/view/2024-513824-41-00